EU clinical trial 2023-508329-28-00: A Randomized, Double-Blind, Placebo-Controlled, Multicenter Trial to Evaluate the Efficacy and Safety of Eblasakimab in Male or Female Moderate-to-Severe Atopic Dermatitis Patients Previously Treated with Dupilumab.
Protocol code: ASLAN004-004
Sponsor: Aslan Pharmaceuticals Pte Ltd (Pharmaceutical company). Phase: Therapeutic exploratory (Phase II). Countries: Poland (authorised, recruitment pending), Germany (authorised, recruitment pending).
Therapeutic area(s): Diseases [C] - Skin and Connective Tissue Diseases [C17]
Gender: Female, Male. Age: 18-64 years, 65+ years. Enrolment: 50.
Status: Authorised, recruitment pending. Decision date: 2024-05-31. Results received: No. Last updated: 2024-05-31.
Decision dates by country: DE: 2024-05-31, PL: 2024-05-31

Condition(s): Atopic Dermatitis
Product: The placebo will consist solely of the excipients of eblasakimab, i.e., the same formulation without the active ingredient and will be identical in appearance to eblasakimab. Pharmaceutical form: Solution for SC injection

Primary endpoint: Percentage change in EASI score from Baseline to Week 16
Endpoint(s): • Proportion of participants achieving vIGA response of 0 (clear) or 1 (almost clear) [5-point scale] at Week 16, • Proportion of participants with a 75% reduction from Baseline in EASI (EASI 75) at Week 16, • Proportion of participants achieving EASI 50 and EASI 90 at Week 16, • Proportion of participants with EASI <7 at Week 16, • Absolute and percent change in peak P-NRS from Baseline to Week 16, • Proportion of participants achieving a 4-point reduction in peak PNRS at Week 16, • Change in BSA affected with AD from Baseline to Week 16, • Change in SCORAD from Baseline to Week 16, • Change in DLQI from Baseline to Week 16, • Change in POEM from Baseline to Week 16, • Change in EQ-5D-5L from Baseline to Week 16, • Absolute and percent change in SD-NRS from Baseline to Week 16, •Proportion of participants achieving a 4-point reduction in SD-NRS at Week 16, • Change in all efficacy endpoints from Baseline over time, • AEs and SAEs, including incidence of clinically significant changes in vital signs, clinical laboratory tests, and ECGs.

Source: https://euclinicaltrials.eu/ctis-public/view/2023-508329-28-00